EU clinical trial 2023-508815-22-00: ISIS 678354-CS7: An Open-Label Study of AKCEA-APOCIII-LRX Administered Subcutaneously to Patients With Familial Chylomicronemia Syndrome (FCS) Previously Treated With Volanesorsen (ISIS 304801)
Protocol code: ISIS 678354-CS7
Sponsor: Ionis Pharmaceuticals Inc. (Pharmaceutical company). Phase: Therapeutic confirmatory (Phase III). Countries: Sweden (ongoing, recruiting).
Therapeutic area(s): Diseases [C] - Congenital, Hereditary, and Neonatal Diseases and Abnormalities [C16]
Gender: Female, Male. Age: 18-64 years, 65+ years. Enrolment: 1.
Status: Ongoing, recruiting. Start date (EU): 2022-02-25. Decision date: 2023-12-05. Results received: No. Last updated: 2026-04-09.

Condition(s): Familial Chylomicronemia Syndrome
Product: ISIS 678354

Primary endpoint: 1. Safety endpoints include a proportion of patients who show the following changes from Baseline to Week 53, Week 105, Week 157 and Week 209 :-Decrease in platelet (PLT) count by>30% -Decrease in PLT count by>50% - PLT count value<50,000mm3 -Major bleeding events -Clinically relevant non-major bleeding events -Decrease in eGFR by>30% -Decrease in eGFR by>50% - UPCR≥1000mg/g -UACR≥500mg/g- ALT or AST>5×ULN- Total bilirubin>2.0mg/dL- ALT or AST>3×ULN and total bilirubin≥2xULN, 2. Tolerability assessments will include adverse events (AEs), clinical laboratory test, and use of concomitant medications
Endpoint(s): 1. PK assessments include determination of trough (pre-dose) and post-treatment plasma ISIS 678354 concentrations, 2. PD endpoints include: 1. Change and percent change from Baseline to Week 53, Week 105, Week 157 and Week 209 in fasting: - Triglycerides (TG) - APOC-III, very low-density lipoprotein (VLDL)-C, chylomicron-TG, total cholesterol (TC), non-HDL-C, low-density lipoprotein (LDL)-C, apoB, apoB48, HDL-C, ApoA-1 2. Event rate of acute pancreatitis (Week 1 through Weeks: 53, 105, and 157)

Source: https://euclinicaltrials.eu/ctis-public/view/2023-508815-22-00